EU clinical trial 2022-501183-17-00: First-in-human phase I/IIa study investigating inhaled CIS-DPI as add-on treatment in Stage IV NSCLC patients
Protocol code: CIS-DPI-01
Sponsor: Inhatarget Therapeutics (Pharmaceutical company). Phase: Phase I and Phase II (Integrated)- First administration to humans. Countries: Belgium (ended), France (ended), Spain (ended).
Therapeutic area(s): Diseases [C] - Neoplasms [C04]
Gender: Female, Male. Age: 18-64 years, 65+ years. Enrolment: 64.
Status: Ended. Start date (EU): 2023-02-23. End date (EU): 2025-10-29. Decision date: 2022-12-06. Results received: No. Last updated: 2025-07-24.
Decision dates by country: BE: 2022-12-06, FR: 2024-09-19, ES: 2024-09-23

Condition(s): Non-Small Cell Lung Cancer

Source: https://euclinicaltrials.eu/ctis-public/view/2022-501183-17-00